EU clinical trial 2022-500391-62-00: A Phase 1-2, Open-Label Study of the Safety, Pharmacokinetics, Pharmacodynamics, and Preliminary Activity of Tolinapant in Combination with Oral Decitabine/Cedazuridine and Oral Decitabine/Cedazuridine Alone in Subjects with Relapsed/Refractory Peripheral T-cell Lymphoma
Protocol code: ASTX660-03
Sponsor: Taiho Oncology Inc. (Pharmaceutical company). Phase: Phase I and Phase II (Integrated)- Other. Countries: France (ended), Spain (ended), Italy (ended), Hungary (ended), Poland (ended).
Therapeutic area(s): Diseases [C] - Immune System Diseases [C20]; Diseases [C] - Neoplasms [C04]; Diseases [C] - Hemic and Lymphatic Diseases [C15]
Gender: Female, Male. Age: 18-64 years, 65+ years. Enrolment: 77.
Status: Ended. Start date (EU): 2023-01-19. End date (EU): 2026-07-01. End date: 2026-07-02. Decision date: 2022-11-23. Results received: Yes. Last updated: 2026-03-11.
Decision dates by country: HU: 2022-11-28, FR: 2022-11-24, IT: 2022-11-24, PL: 2023-05-08, ES: 2022-11-23

Condition(s): Subjects with relapsed/refractory peripheral T-cell lymphoma (R/R PTCL)
Product: Tolinapant, Tolinapant, ASTX727

Primary endpoint: Phase 1: Incidence and severity of treatment-emergent adverse events (TEAEs) including serious adverse events (SAEs) and dose limiting toxicities (DLTs)., Phase 2: Antitumor activity assessed by ORR using 2014 Lugano Classification (Cheson et al 2014; Cheson 2015) using computerized tomography (CT) imaging as the primary modality as assessed by the investigator.
Endpoint(s): Phase 1: Oral decitabine/cedazuridine alone arm: Incidence and severity of TEAEs including SAEs and DLTs., Phase 1 and Phase 2: PK parameters of tolinapant and oral decitabine/cedazuridine, as well as oral decitabine/cedazuridine alone, including area under the concentration-time curve (AUC), maximum observed concentration (Cmax), minimum observed concentration at steady state (Cmin), time to maximum observed concentration (Tmax), apparent elimination half life (t½), and other secondary PK parameters., Phase 2: Duration of response (DOR), complete response (CR), partial response (PR), progression-free survival (PFS), disease control rate (DCR) and overall survival (OS) using the Lugano classification (Cheson et al 2014 and Cheson 2015) using CT imaging as the primary modality. - DOR, CR, PR, PFS, DCR, and OS using the Lugano classification (Cheson et al 2014 and Cheson 2015) using CT along with PET imaging assessments., Phase 2: Anti-tumor activity (ORR, DOR, CR, PR, and PFS) based on assessment using 2014 Lugano Classification with Lymphoma Response to Immunomodulatory Therapy Criteria (LYRIC) (Cheson et al 2016). - Anti-tumor activity (ORR, DOR, DCR, CR, and PR) based on PTCL subtypes (using both pathology and molecular markers)., Phase 2: Response assessments performed by both the investigator and blinded independent central radiologist.

Source: https://euclinicaltrials.eu/ctis-public/view/2022-500391-62-00